EU clinical trial 2024-514198-23-00: A Phase I, Randomised, Open Label, Single Center, Single Oral Dose, Three Treatment, Three Period, Three Sequence, Change-over Bioequivalence Study of Paracetamol Orodispersible Tablet 500 mg (Haleon) to assess Bioequivalence with Alvedon 500 mg Film-Coated Tablet (Haleon, Sweden) and Panadol 500 mg Film-Coated Tablet (Haleon, Australia) in Healthy Adult Subjects Under Fasting Conditions
Protocol code: 300141
Sponsor: Haleon CH SARL (Pharmaceutical company). Phase: Human Pharmacology (Phase I)- Bioequivalence Study. Countries: Germany (ended).
Therapeutic area(s): Not possible to specify
Gender: Female, Male. Age: 18-64 years. Enrolment: 54.
Status: Ended. Start date (EU): 2025-03-05. End date (EU): 2025-06-16. Decision date: 2024-12-10. Results received: No. Last updated: 2025-06-04.

Condition(s): Healthy volunteers, therapeutic indication not studied

Source: https://euclinicaltrials.eu/ctis-public/view/2024-514198-23-00